EU clinical trial 2024-511844-18-00: A Phase I/IIa multicenter study evaluating the safety and efficacy of CAR20(NAP)-T in patients with relapsed/refractory B cell lymphoma (CARMA-01)
Protocol code: ELC301-CARMA-01
Sponsor: Uppsala Universitet (Educational Institution). Phase: Phase I and Phase II (Integrated)- First administration to humans. Countries: Sweden (ongoing, recruiting).
Therapeutic area(s): Diseases [C] - Neoplasms [C04]
Gender: Female, Male. Age: 18-64 years, 65+ years. Enrolment: 30.
Status: Ongoing, recruiting. Start date (EU): 2024-05-02. Decision date: 2024-09-02. Results received: No. Last updated: 2025-07-21.

Condition(s): Relapsed or refractory CD20+ diffuse large B-cell lymphoma, mantle cell lymphoma or indolent lymphoma

Source: https://euclinicaltrials.eu/ctis-public/view/2024-511844-18-00